EU clinical trial 2024-512390-27-00: A first-in-human dose escalation and expansion study with the SIRPα-directed monoclonal antibody BYON4228 alone and in combination with rituximab to evaluate the safety, pharmacokinetics, pharmacodynamics and efficacy in patients with relapsed/refractory CD20 positive B-cell Non-Hodgkin’s Lymphoma (NHL)
Protocol code: BYON4228.001
Sponsor: Byondis B.V. (Pharmaceutical company). Phase: Human Pharmacology (Phase I)- First administration to humans. Countries: Spain (ended), Italy (ended), Netherlands (ongoing, recruitment ended).
Therapeutic area(s): Diseases [C] - Hemic and Lymphatic Diseases [C15]
Gender: Female, Male. Age: 18-64 years, 65+ years. Enrolment: 66.
Start date (EU): 2023-06-09. Decision date: 2024-07-03. Results received: No. Last updated: 2026-04-08.
Decision dates by country: NL: 2024-07-04, ES: 2024-07-03, IT: 2024-07-08

Condition(s): Relapsed/refractory CD20 positive B-cell Non-Hodgkin's Lymphoma (NHL)

Source: https://euclinicaltrials.eu/ctis-public/view/2024-512390-27-00